EU clinical trial 2023-506772-28-00: J1S-MC-JP04: A Randomized, Open-Label Phase 2 Study Evaluating Abemaciclib in Combination with Irinotecan and Temozolomide in Participants with Relapsed or Refractory Ewing’s Sarcoma
Protocol code: J1S-MC-JP04
Sponsor: Eli Lilly & Co. (Pharmaceutical company). Phase: Therapeutic exploratory (Phase II). Countries: Italy (ended), Spain (ended), France (ended), Germany (ended).
Therapeutic area(s): Diseases [C] - Neoplasms [C04]
Gender: Female, Male. Age: 0-17 years, 18-64 years. Enrolment: 30.
Status: Ended. Start date (EU): 2022-10-07. End date (EU): 2025-07-19. Decision date: 2024-03-04. Results received: No. Last updated: 2025-04-30.
Decision dates by country: FR: 2024-03-22, ES: 2024-03-04, DE: 2024-03-07, IT: 2024-03-11

Condition(s): Ewings Sarcoma
Product: Verzenios 50 mg film-coated tablets, TEMOZOLOMIDE, IRINOTECAN, Abemaciclib, Abemaciclib

Primary endpoint: Progression Free Survival as determined by blinded independent review committee using Response Evaluation Criteria in Solid Tumors, Version 1.1 (RECIST 1.1)

Source: https://euclinicaltrials.eu/ctis-public/view/2023-506772-28-00